EU clinical trial 2025-523499-22-00: An Open-Label Study of Donidalorsen in Pediatric Patients Age 2 to Less than 12 Years Old with Hereditary Angioedema [Donidalorsen Treatment in Children with Hereditary Angioedema]
Protocol code: ISIS 721744-CS8
Sponsor: Ionis Pharmaceuticals Inc. (Pharmaceutical company). Phase: Therapeutic confirmatory (Phase III). Countries: Italy (ongoing, recruiting), Spain (authorised, recruiting), Poland (authorised, recruiting).
Therapeutic area(s): Phenomena and Processes [G] - Genetic Phenomena [G05]; Diseases [C] - Congenital, Hereditary, and Neonatal Diseases and Abnormalities [C16]
Gender: Female, Male. Age: 0-17 years. Enrolment: 8.
Start date (EU): 2026-04-01. Decision date: 2026-02-25. Results received: No. Last updated: 2026-05-05.
Decision dates by country: IT: 2026-02-25, PL: 2026-02-26, ES: 2026-03-02

Condition(s): Hereditary Angioedema (HAE)
Product: ISIS 721744, ISIS 721744

Primary endpoint: 1. Incidence and severity of treatment-emergent adverse events (TEAEs), 2. Plasma pharmacokinetics and concentrations of donidalorsen
Endpoint(s): 1. The time-normalized number of investigator-confirmed HAE attacks (per month) over the period of 12 months., 3. The percentage of investigator-confirmed HAE attack-free participants over the period of 12 months., 4. The time-normalized number of moderate or severe investigatorconfirmed HAE attacks (per month) over the period of 12 months., 5. The number of participants with a clinical response defined as a ≥ 50%, ≥ 70%, or ≥ 90% reduction from Baseline in investigator-confirmed HAE attack rate over the period of 12 months., 6. The number of investigator-confirmed HAE attacks requiring rescue treatment (i.e., acute therapy) over the period of 12 months., 7. Change in PKK levels in plasma over the period of 12 months., 8. Changes in Pediatrics Quality of Life (PedsQL) scores for participants over the period of 12 months.

Source: https://euclinicaltrials.eu/ctis-public/view/2025-523499-22-00